EU clinical trial 2024-519504-27-00: An Open-label, Randomized Phase 3 Study of Linvoseltamab Monotherapy and Linvoseltamab plus Carfilzomib versus Standard of Care Combination Regimens in Patients with Relapsed/Refractory Multiple Myeloma
Protocol code: R5458-ONC-2246
Sponsor: Regeneron Pharmaceuticals Inc. (Pharmaceutical company). Phase: Therapeutic confirmatory (Phase III). Countries: Greece (authorised, recruitment pending), Spain (authorised, recruitment pending), Poland (authorised, recruitment pending), Italy (authorised, recruitment pending), Austria (authorised, recruitment pending), Czechia (authorised, recruitment pending), Belgium (authorised, recruitment pending), Germany (authorised, recruitment pending), Netherlands (authorised, recruitment pending), France (authorised, recruitment pending).
Therapeutic area(s): Diseases [C] - Neoplasms [C04]
Gender: Female, Male. Age: 18-64 years, 65+ years. Enrolment: 315.
Status: Authorised, recruitment pending. Decision date: 2026-02-10. Results received: No. Last updated: 2026-04-09.
Decision dates by country: AT: 2026-02-16, BE: 2026-02-10, FR: 2026-02-16, DE: 2026-02-16, GR: 2026-02-12, IT: 2026-02-13, ES: 2026-02-13, NL: 2026-02-12, CZ: 2026-02-10, PL: 2026-02-16

Condition(s): Relapsed Refractory Multiple Myeloma
Product: DEXAMETHASONE, Dexamethasonfosfaat Accord 4 mg/ml oplossing voor injectie/infusie, Kyprolis 10 mg powder for solution for infusion, Paracetamol 1000mg Tablets, Imnovid 2 mg hard capsules, Imnovid 1 mg hard capsules, DARZALEX 1800 mg solution for injection, LYNOZYFIC 200 mg concentrate for solution for infusion, Dermodrin 30 mg/2 ml soluție injectabilă, Imnovid 3 mg hard capsules, DEXAMETHASONE, Co-Trimoxazole 80/400mg Tablets, Kyprolis 30 mg powder for solution for infusion, LYNOZYFIC 5 mg concentrate for solution for infusion, Diphenhydramine Hydrochloride Tablets 25 mg, Paracetamol 10 mg/ mL solution for infusion, Imnovid 4 mg hard capsules, Kyprolis 60 mg powder for solution for infusion, VELCADE 3.5 mg powder for solution for injection, Aciclovir 200 mg Tablets, Dexamethasone Medochemie 8 mg/2 ml süste-/infusioonilahus

Primary endpoint: Part 1 - Occurrence of Treatment Emergent Adverse Events (TEAEs), Part 1 - Severity of TEAEs, Part 1 - Occurrence of Adverse Events of Special Interest (AESI), Part 1 - Severity of AESIs, Part 1 - Occurrence of Serious Adverse Events (SAEs), Part 1 - Severity of SAEs, Part 2 - Minimal Residual Disease (MRD) -negative Complete response (CR), Part 2 - Progression-Free Survival (PFS) per IMWG response criteria as determined by BIRC
Endpoint(s): Part 1 - Occurrence of grade ≥2 Cytokine Release Syndrome (CRS), Part 1 - Timing of grade ≥2 CRS, Part 2 - Overall Survival (OS), Part 2 - Achievement of Partial Response (PR) or better per IMWG response criteria as determined by BIRC, Part 2 - Achievement of Very Good Partial Response (VGPR) or better per IMWG response criteria as determined by BIRC, Part 2 - Achievement of CR or better per IMWG response criteria as determined by BIRC, Part 2 - Duration Of Response (DOR) as per IMWG response criteria, Part 2 - Time To Progression (TTP) as per IMWG response criteria, Part 2 - Time To Next Treatment (TTNT), Part 2 - Second PFS, Part 2 - MRD-negative CR criteria at any time, Part 2 - Time to PR IMWG response category, Part 2 - Time to VGPR IMWG response category, Part 2 - Time to CR IMWG response category, Part 2 - Time to stringent Complete Response (sCR) IMWG response category, Part 2 - Sustained of MRD-negative CR, Part 2 - Duration of MRD-negative CR, Part2 - Occurrence of TEAEs, Part 2 - Severity of TEAEs, Part 2 - Occurrence of AESIs, Part 2 - Severity of AESIs, Part 2 - Occurrence of SAEs, Part 2 - Severity of SAEs, Part 2 - Concentrations of linvoseltamab in serum over time, Part 2 - Incidence of Antidrug Antibodies (ADAs) to linvoseltamab, Part 2 - Magnitude of ADAs to linvoseltamab, Part 2 - Concentrations total soluble B-cell Maturation Antigen (sBCMA) in serum over time, Part 2 - Change from baseline in Global Health Status (GHS)/Quality of Life (QoL), per European Organization for Research and Treatment of Cancer Quality of Life Questionnaire (EORTCQLQ-C30), Part 2 - Change from baseline in Physical Functioning (PF), per EORTC QLQ-C30, Part 2 - Change from baseline in Role Functioning (RF), per EORTC QLQ-C30, Part 2 - Change from baseline in pain, per EORTC QLQ-C30, Part 2 - Change from baseline in fatigue, per EORTC QLQ-C30, Part 2 - Change in patient reported Disease Symptoms (DS) per EORTC Quality of Life Questionnaire-Multiple Myeloma (MM) module 20 [QLQ-MY20]), Part 2 - Change in patient reported Treatment Side Effects (TSE) per EORTC QLQ-MY20, Part 2 - Change in patient-reported health state per EuroQoL-5 Dimension-5 Level Scale [EQ-5D-5L]) Visual Analogue Scale (VAS), Part 2 - Change in patient-reported overall impact of treatment per Functional Assessment of Chronic Illness Therapy (FACIT) item GP5

Source: https://euclinicaltrials.eu/ctis-public/view/2024-519504-27-00